EU clinical trial 2024-513858-29-01: IDEAL STUDY - A single-arm phase II multicenter study of IDH2 (AG-221) inhibitor in patients with IDH2 mutated myelodysplastic syndrome
Protocol code: AG221CLMDSGFM13217
Sponsor: Groupe Francophone Des Myelodysplasies (Patient organisation/association). Phase: Therapeutic exploratory (Phase II). Countries: Germany (ended), France (ongoing, recruitment ended).
Therapeutic area(s): Diseases [C] - Hemic and Lymphatic Diseases [C15]
Gender: Female, Male. Age: 18-64 years, 65+ years. Enrolment: 68.
Start date (EU): 2019-02-06. Decision date: 2024-12-31. Results received: No. Last updated: 2026-06-12.
Decision dates by country: FR: 2024-12-31, DE: 2025-01-02

Condition(s): myelodysplastic syndrome with IDH2 mutated
Product: Enasidenib Mesilate, Enasidenib Mesilate

Primary endpoint: Overall hematological response at 3 and 6 months (including CR, PR, stable disease with HI according to IWG 2006) for cohort A and B; SAFETY FOR COHORT C
Endpoint(s): Response duration and Time response, Time to IPSS and IPSS-R progression, Rate and time to AML evolution, Overall survival, Cytogenetic and molecular response, Prognostic factors of response, including IPSS-R, IPSS-karyotype and somatic mutations, Evolution of IDH2 VAF on therapy, Adverse events and toxicity as measured by NCI CTCAE 5

Source: https://euclinicaltrials.eu/ctis-public/view/2024-513858-29-01